EU clinical trial 2022-500306-17-00: A multi-center, randomized, active controlled clinical trial to evaluate the efficacy and safety of OTL-203 in subjects with mucopolysaccharidosis type I, Hurler syndrome (MPS-IH) compared to standard of care with allogeneic hematopoietic stem cell transplantation (allo-HSCT)
Protocol code: OTL-203-02
Sponsor: Orchard Therapeutics (Europe) Limited (Pharmaceutical company). Phase: Therapeutic confirmatory (Phase III). Countries: Italy (ongoing, recruitment ended), Netherlands (ongoing, recruitment ended).
Therapeutic area(s): Diseases [C] - Nutritional and Metabolic Diseases [C18]; Diseases [C] - Congenital, Hereditary, and Neonatal Diseases and Abnormalities [C16]
Gender: Female, Male. Age: 0-17 years. Enrolment: 11.
Status: Ongoing, recruitment ended. Start date (EU): 2024-09-20. Decision date: 2024-04-23. Results received: No. Last updated: 2026-07-01.
Decision dates by country: NL: 2024-04-23, IT: 2024-04-29

Condition(s): Mucopolysaccharidosis type I, Hurler Syndrome
Product: PLERIXAFOR, FLUDARABINE, OTL-203, RITUXIMAB, LARONIDASE, BUSULFAN

Primary endpoint: Event-free survival (EFS; composite endpoint) at Year 2 (the primary analysis timepoint) defined by the following events: 1. Death post-treatment 2. Rescue allo-HSCT 3. Treatment Failure 4. Immunological complications 5. Severe Cognitive Impairment 6. Short Stature.
Endpoint(s): • Change from Baseline (CFB) to Year 2 in IDUA activity in leukocytes • CFB to Year 2 in urinary heparan sulfate levels, defined as ratio to the upper limit of normal (ULN)., Long Term EFS at the time of the final analysis., The following endpoints will be assessed at each visit scheduled in the SoA: Cognitive Function, Joint Range Motion, Dysostosis Multiplex, Auditory function, Visual function and corneal clouding, Imaging, Presence of cardiac abnormalities associated with MPS-I, Motor Function, Functional Capacity, Auxological measurements, Quality of Life (QoL) and Activities of Daily Living (ADLs)., Healthcare resource utilization (HRU) and Surgical Burden., Assessments of Engraftment and Pharmacodynamic Effects., Safety of OTL-203 compared to allo-HSCT procedure as measured by: overall incidence of adverse events (AEs), NIMP/AxMP-related AEs, Study Procedure-related AEs, Disease-related AEs, Treatment related AEs, Serious adverse events (SAEs). Immune response against IDUA enzyme (anti-IDUA antibodies), evaluated via immunoassay. Malignancy or Abnormal Clonal Proliferation (ACP). Emergence of Replication Competent Lentivirus (RCL).

Source: https://euclinicaltrials.eu/ctis-public/view/2022-500306-17-00